EU clinical trial 2024-513308-32-00: OFOBA : Opioid-Free versus Opioid-Based Anaesthesia for free-flap reconstruction surgery of the breast: A phase III multicentric randomized controlled study.
Protocol code: IC 2021-07
Sponsor: Institut Curie (Hospital/Clinic/Other health care facility). Phase: Therapeutic confirmatory (Phase III). Countries: France (ongoing, recruiting).
Therapeutic area(s): Diseases [C] - Neoplasms [C04]
Gender: Female. Age: 18-64 years, 65+ years. Enrolment: 158.
Status: Ongoing, recruiting. Start date (EU): 2022-12-07. Decision date: 2024-05-07. Results received: No. Last updated: 2025-12-22.

Condition(s): Anaesthesia during free flap reconstruction surgery of the breast.

Source: https://euclinicaltrials.eu/ctis-public/view/2024-513308-32-00